EU clinical trial 2024-519969-21-00: Oral antimicrobial treatment vs. outpatient parenteral for infective endocarditis
Protocol code: OraPAT-IE GAMES
Sponsor: Fundacio De Recerca Clinic Barcelona-Institut D’Investigacions Biomediques August Pi I Sunyer (Laboratory/Research/Testing facility). Phase: Therapeutic use (Phase IV). Countries: Spain (ongoing, recruiting).
Therapeutic area(s): Diseases [C] - Cardiovascular Diseases [C14]
Gender: Female, Male. Age: 18-64 years, 65+ years. Enrolment: 342.
Status: Ongoing, recruiting. Start date (EU): 2025-01-01. Decision date: 2025-01-15. Results received: No. Last updated: 2025-12-16.

Condition(s): Infective endocarditis
Product: AMOXICILINA NORMON 1000 mg Comprimidos EFG

Primary endpoint: Composite endpoint (whatever happen first) of unplanned hospitalization due to any reason, all-cause mortality, unplanned cardiac surgery and IE relapse within six months from diagnosis
Endpoint(s): To evaluate quality of life and patient satisfaction, To evaluate costs of both interventions through a pharmacoeconomic analysis., To evaluate number complications related to parenteral administration and oral administration of antibiotics (such as catheter related infections, Cl difficile diarrhea,among others)., Unplanned hospitalization, all-cause mortality, unplanned cardiac surgery and relapse of IE rates for each variable

Source: https://euclinicaltrials.eu/ctis-public/view/2024-519969-21-00